EU clinical trial 2023-505614-17-00: A Phase 3 Randomized, Open-Label, Study of Pembrolizumab (MK-3475) Plus Lenvatinib (E7080/MK-7902) Versus Chemotherapy for First-line Treatment of Advanced or Recurrent Endometrial Carcinoma (LEAP-001)
Protocol code: MK-7902-001
Sponsor: Merck Sharp & Dohme LLC (Pharmaceutical company). Phase: Therapeutic confirmatory (Phase III). Countries: Ireland (ended), Austria (ended), Italy (ended), Spain (ended), Belgium (ended), Germany (ended), Poland (ended).
Therapeutic area(s): Diseases [C] - Neoplasms [C04]
Gender: Female, Male. Age: 18-64 years, 65+ years. Enrolment: 143.
Status: Ended. Start date (EU): 2019-09-20. End date (EU): 2025-01-13. End date: 2025-02-05. Decision date: 2023-10-09. Results received: Yes. Last updated: 2025-02-03.
Decision dates by country: BE: 2023-10-11, IE: 2023-10-09, DE: 2023-10-10, AT: 2023-10-10, ES: 2023-10-16, PL: 2023-10-16, IT: 2023-10-10

Condition(s): Participants with advanced or recurrent endometrial carcinoma
Product: KEYTRUDA 25 mg/mL concentrate for solution for infusion, Lenvatinib, CARBOPLATIN, PACLITAXEL, Lenvatinib

Primary endpoint: Progression-free survival (PFS) based on Response Evaluation Criteria in Solid Tumors version 1.1 (RECIST 1.1) as assessed by blinded independent central review (BICR), modified to follow a maximum of 10 target lesions and a maximum of 5 target lesions per organ, Overall Survival
Endpoint(s): Objective response rate (ORR; either confirmed complete response [CR] or partial response [PR]) based on Response Evaluation Criteria in Solid Tumors version 1.1 (RECIST 1.1) as assessed by blinded independent review (BICR) in mismatch repair proficient (pMMR) participants and in all-comer participants who have measurable disease at study entry, Change from baseline in Health-Related Quality-of-Life (HRQoL) global score of the European Organization for Research and Treatment of Cancer (EORTC) Quality of Life Questionnaire Core-30 (QLQ C30) in pMMR and in all-comer participants, Percentage of participants experiencing an adverse event (AE), Percentage of participants experiencing a serious AE (SAE), Percentage of participants experiencing an immune-related AE (irAE), Percentage of participants discontinuing from study treatment due to an AE(s)

Source: https://euclinicaltrials.eu/ctis-public/view/2023-505614-17-00